EU clinical trial 2025-521889-95-00: Efficacy of MIrikizumab to achieve traNsmural healing in patiENTs with Crohn’s Disease : EMINENT CD
Sponsor: Groupe D'etude Therapeutique Des Affections Inflammatoires Du Tube Digestif (Laboratory/Research/Testing facility). Phase: Therapeutic use (Phase IV). Countries: France (ongoing, recruiting).
Therapeutic area(s): Diseases [C] - Digestive System Diseases [C06]
Gender: Female, Male. Age: 18-64 years, 65+ years. Enrolment: 110.
Status: Ongoing, recruiting. Start date (EU): 2026-05-04. Decision date: 2026-02-05. Results received: No. Last updated: 2026-05-18.

Condition(s): Crohn's Disease
Product: Omvoh 100 mg solution for injection in pre-filled pen, Omvoh 300 mg concentrate for solution for infusion, Omvoh 100 mg + 200 mg solution for injection in pre-filled pen, Omvoh 300 mg concentrate for solution for infusion, Omvoh 100 mg solution for injection in pre-filled pen, Omvoh 200 mg solution for injection in pre-filled syringe, Omvoh 100 mg solution for injection in pre-filled pen, Omvoh 100 mg + 200 mg solution for injection in pre-filled pen, Omvoh 100 mg solution for injection in pre-filled pen, Omvoh 200 mg solution for injection in pre-filled syringe, Omvoh 300 mg concentrate for solution for infusion, Omvoh 300 mg concentrate for solution for infusion, Omvoh 100 mg solution for injection in pre-filled pen, Omvoh 100 mg + 200 mg solution for injection in pre-filled pen, Omvoh 300 mg concentrate for solution for infusion, Omvoh 100 mg solution for injection in pre-filled pen, Omvoh 300 mg concentrate for solution for infusion, Omvoh 200 mg solution for injection in pre-filled syringe, Omvoh 100 mg + 200 mg solution for injection in pre-filled pen, Omvoh 100 mg solution for injection in pre-filled pen, Omvoh 100 mg solution for injection in pre-filled pen, Omvoh 200 mg solution for injection in pre-filled syringe, Omvoh 100 mg + 200 mg solution for injection in pre-filled pen, Omvoh 200 mg solution for injection in pre-filled syringe, Omvoh 100 mg + 200 mg solution for injection in pre-filled pen, Omvoh 100 mg + 200 mg solution for injection in pre-filled pen, Omvoh 100 mg solution for injection in pre-filled pen, Omvoh 100 mg solution for injection in pre-filled pen, Omvoh 300 mg concentrate for solution for infusion, Omvoh 100 mg solution for injection in pre-filled pen, Omvoh 200 mg solution for injection in pre-filled syringe, Omvoh 200 mg solution for injection in pre-filled syringe, Omvoh 100 mg + 200 mg solution for injection in pre-filled pen, Omvoh 200 mg solution for injection in pre-filled syringe, Omvoh 300 mg concentrate for solution for infusion, Omvoh 100 mg solution for injection in pre-filled pen

Primary endpoint: Transmural response (TR25): decrease of at least (>=) 25% of C-score in each and all active segment from baseline to week 24
Endpoint(s): Composite endpoint combining clinical remission and transmural response (TR25) at 6 months, Clinical remission will be defined according to PRO-2, Transmural response will be defined as a decrease of at least 25% of C-score in each active segment at baseline, Improvement or normalization of bowel urgency according to UNRS and Urgent score BU clinical meaningful improvement was defined as decrease of >=3 points, BU Remission was defined as UNRS =<2, Transmural response (TR50): decrease of at least 50% of C-score in each active segment at baseline, Transmural healing: C-score < 0.5 in each active segment at baseline/TRENCH definition, Complete transmural healing: C-score = 0 in each active segment at baseline, MaRIA at 6 months, IUS transmural response/healing at week 4,8, 12 and 24, Bowel damage (Lemann Index) at 6 and 18 months, Clinical response and remission at week 4,8, 12 and 24, Biochemical remission at week 4,8, 12 and 24, Drug retention, IBD-disability index, IBDQ, 10 points-Acceptability numerical scale (ANS), Adverse events and severe adverse events

Source: https://euclinicaltrials.eu/ctis-public/view/2025-521889-95-00